EU clinical trial 2024-513423-16-00: A randomized, double-blind, placebo controlled study assessing the long-term effect of dupilumab on prevention of lung function decline in patients with uncontrolled moderate to severe asthma (ATLAS)
Protocol code: LPS16676
Sponsor: Sanofi-Aventis Recherche & Developpement (Pharmaceutical company). Phase: Therapeutic use (Phase IV). Countries: Ireland (ongoing, recruitment ended), Bulgaria (ongoing, recruitment ended), Hungary (ongoing, recruitment ended), Romania (ongoing, recruitment ended), Belgium (ongoing, recruitment ended), Greece (ongoing, recruitment ended), Slovakia (ongoing, recruitment ended).
Therapeutic area(s): Diseases [C] - Respiratory Tract Diseases [C08]
Gender: Female, Male. Age: 18-64 years, 65+ years. Enrolment: 506.
Status: Ongoing, recruitment ended. Start date (EU): 2022-08-25. Decision date: 2024-07-09. Results received: No. Last updated: 2026-07-13.
Decision dates by country: BE: 2024-07-15, BG: 2024-07-18, HU: 2024-07-09, SK: 2024-07-10, GR: 2024-09-25, RO: 2024-07-11, IE: 2024-07-09

Condition(s): Asthma
Product: dupilumab placebo, solution for injection in pre-filled syringe, Dupilumab

Primary endpoint: Rate of change from week 8 to week 52 on post-BD FEV1 slope in FeNO population
Endpoint(s): Rate of change from week 8 to week 52 on post-BD FEV1 slope in the Total population, Rate of change from week 8 to week 104 on post-BD FEV1 slope in the FeNO population, Change from baseline to week 52 in pre-BD FEV1 in FeNO and Total populations, Change from baseline to week 52 in post-BD FEV1 in FeNO and Total populations, Annualized severe exacerbation rate during the 52-week period in FeNO and Total populations, Change from baseline to week 52 in fractional exhaled nitric oxide (FeNO) levels in FeNO and Total populations, Change from baseline to week 52 in Asthma Control Questionnaire 7 items (ACQ-7) in FeNO and Total populations, Change from baseline to week 52 in pre-BD FEV1 % predicted in FeNO and Total populations, Change from baseline to week 52 in Forced Vital Capacity (FVC) in FeNO and Total populations, Rate of change from week 8 to week 104 on post-BD FEV1 slope in Total Population, Change from baseline to week 104 in pre-BD FEV1 in FeNO and Total populations, Change from baseline to week 104 in post-BD FEV1 in FeNO and Total populations, Annualized severe exacerbation rate during the 104-week period in FeNO and Total populations, Change from baseline to week 104 in FeNO levels in FeNO and Total populations, Change from baseline to week 104 in ACQ-7 in FeNO and Total populations, Change from baseline to week 104 in pre-BD FEV1 % predicted in FeNO and Total populations, Change from baseline to week 104 FVC in FeNO and Total populations, Change from baseline to week 52 in Asthma Quality Of Life Questionnaire with Standardized Activities (AQLQ(S)) in FeNO and Total populations, Change from baseline to week 104 in AQLQ(S) in FeNO and Total populations, Rate of change from week 8 to week 156 on post-BD FEV1 slope in FeNO and Total populations, Incidence of treatment-emergent adverse events (TEAEs) and serious adverse events (SAEs), Incidence of adverse events of special interest (AESIs)

Source: https://euclinicaltrials.eu/ctis-public/view/2024-513423-16-00